EU clinical trial 2022-502918-87-00: PARP-PET in solid tumors
Protocol code: K 2022-9259
Sponsor: Karolinska University Hospital (Hospital/Clinic/Other health care facility). Phase: Human Pharmacology (Phase I)- Other. Countries: Sweden (ongoing, recruiting).
Therapeutic area(s): Diseases [C] - Neoplasms [C04]
Gender: Female, Male. Age: 18-64 years, 65+ years. Enrolment: 70.
Status: Ongoing, recruiting. Start date (EU): 2023-10-02. Decision date: 2023-08-17. Results received: No. Last updated: 2025-04-10.

Condition(s): cancer patients

Source: https://euclinicaltrials.eu/ctis-public/view/2022-502918-87-00